EU clinical trial 2024-513057-78-00: Frozen Shoulder Treatment with IA Corticosteroid Injection and Suprascapular Nerve Block
Sponsor: UZ Brussel (Hospital/Clinic/Other health care facility). Phase: Therapeutic use (Phase IV). Countries: Belgium (ongoing, recruiting).
Therapeutic area(s): Phenomena and Processes [G] - Musculoskeletal and Neural Physiological Phenomena [G11]; Diseases [C] - Musculoskeletal Diseases [C05]
Gender: Female, Male. Age: 18-64 years, 65+ years. Enrolment: 156.
Status: Ongoing, recruiting. Start date (EU): 2025-02-02. Decision date: 2024-09-16. Results received: No. Last updated: 2026-04-27.

Condition(s): Adhesive Capsulitis, Frozen Shoulder
Product: Depo-Medrol 40 mg/1 ml Suspension Injectable, Linisol 2 % oplossing voor injectie, Ropivacaïne Fresenius Kabi 2 mg/ml oplossing voor injectie, Depo-Medrol 40 mg/1 ml Injektionssuspension

Primary endpoint: The key primary endpoint is the change in shoulder-related disability 3 months after intervention vs control, assessed through a validated questionnaire the Shoulder Pain and Disability Index (SPADI).
Endpoint(s): • An intermediary statistical analysis will be performed at 6 months. In case all 3 outcomes (disability, pain, shoulder stiffness) show non-superiority at 6m, the study will not be ex-tended to the 12-month time point., Pain - Numeric Pain Rating Scale (NPRS) [Time Frame: 4 weeks - 3months - 6months - 12months after the intervention], SPADI [Time Frame: 4 weeks- 6 months - 12months after the intervention], Constant - Murley score (CMS) [Time Frame: 4weeks - 3months - 6months - 12months after the intervention], Health related quality of life, evaluated with the EuroQol EQ-5D 3L [Time Frame: 4weeks - 3months - 6months - 12months after the intervention], PROMIS-29 Upper Extremity v2.0- Physical function [Time Frame: 4weeks - 3 months - 6 months - 12 months after the intervention], Shoulder ROM in abduction, anterior elevation, external rotation [Time Frame: 4weeks - 3months - 6months - 12months after the intervention], Coracoid Pain Test (CPT): The pain severity approach and affected-unaffected approach of the instrument-assisted CPT, as described by Mertens et al. (2022) are used., Distension Test in Passive External Rotation (DTPER): as described by Noboa et al. in 2015 in Revista Esponola De Cirurgia Ortopedica Y Traumatologia [Time Frame: 4weeks - 3months - 6months - 12months after the intervention], Strict passive GH abduction: The patient is seated upright in a chair to limit trunk extension, the scapula and acromion are blocked with one hand of the examiner, while the other hand slowly brings the patient’s arm in maximal abduction, while the patient’s elbow is maintained in 90° flexion. [Time Frame: 4weeks - 3months - 6months - 12months after the intervention], Jobe Test 32: as described by Jobe et al. in 1982 in AJSM [Time Frame: 4weeks - 3months - 6months - 12months after the intervention], Neer Test 33: as described by Neer et al. in 1983 in Clin Rel Orthop Res. [Time Frame: 4weeks - 3months - 6months - 12months after the intervention], Hawkins-Kennedy test 34: as described by Hawkins et al. in 1980 in AJSM [Time Frame: 4weeks - 3months - 6months - 12months after the intervention], Tampa Scale for Kinesiophobia (TSK-11): [Time Frame: 4weeks - 3 months - 6months - 12months after the intervention], Pain Self-Efficacy Questionnaire (PSEQ) [Time Frame: 4weeks - 3months - 6months - 12months after the intervention], Global Rating of Change Score (GRoC) [Time Frame: 4weeks - 3months - 6months - 12months after the intervention], Work Ability Index (WAI) [Time Frame: 4weeks - 3months - 6months - 12months after the intervention], Work Status [Time Frame: 4weeks - 3months - 6months - 12months after the intervention], Healthcare service use [Time Frame: 4weeks - 3months - 6months - 12months after the intervention], Adverse effects [Time Frame: 4weeks - 3months - 6months - 12months after the intervention], Use of rescue therapy [Time Frame: 3months - 6months - 12months after the intervention], Exploratory prediction analysis part I: Through regression analysis the investigators want to find out which factors predict I) SPADI score at 3 -6- 12 months follow-up, II) pain NPR level at 3-6-12 months, III) shoulder ROM (°) at 3-6-12 months and IV) return to work and WAI score at 3-6-12 months., Exploratory prediction analysis part II: Through regression analysis the investigators want to identify which physical examination tests, or which combinations of tests are correlated with MRI diagnostic criteria and a more positive evolution of SPADI score – NPR pain score – shoulder ROM (°)– RTW/WAI score, Exploratory prediction analysis part III: Through regression analysis the investigators want to identify patients that benefit the most from the combined SSNB + IACI

Source: https://euclinicaltrials.eu/ctis-public/view/2024-513057-78-00